EU clinical trial 2024-517083-32-00: A phase 2 clinical trial assessing the efficacy and safety of adding cladribine for treatment modifying course of seropositive myasthenia gravis
Protocol code: MGCDB001
Sponsor: Uniwersytet Medyczny W Lublinie (Educational Institution). Phase: Therapeutic exploratory (Phase II). Countries: Poland (ongoing, recruitment ended).
Therapeutic area(s): Diseases [C] - Immune System Diseases [C20]
Gender: Female, Male. Age: 18-64 years, 65+ years. Enrolment: 200.
Status: Ongoing, recruitment ended. Start date (EU): 2021-12-17. Decision date: 2024-10-13. Results received: No. Last updated: 2026-08-04.

Condition(s): Myasthenia gravis
Product: sodium chloride, sól fizjologiczna (0,9%NaCl), CLADRIBINE

Primary endpoint: Changes in the evaluation of the effects of intensified myasthenia symptoms on the daily living activities according to the Myasthenia Gravis Activities of Daily Living (MG-ADL) scale during visits assessing efficacy: W2 – W8 during the basic examination time and W10 – W15 during additional testing time, comparing to the baseline result (W1 in the basic study period and W9 in the additional study time).
Endpoint(s): Reduction in the requirement for simultaneous oral corticosteroids used in immunotherapy (steroid-sparing effect). The endpoint will only be assessed in the core cohort. Assessment for W4-W8 during the basic duration of the study and W12-W15 during the additional duration of the study., Incidence of the need for rescue therapy due to exacerbation of myasthenia gravis with respiratory failure at any time during the study period, separately in the primary and secondary study periods., Change in antibodies against acetylcholine receptors (anti-AChR-ab) and specific muscle tyrosine kinase (anti-MUSK-ab) in blood serum compared to the baseline result (on W1 during the basic study period and on W9 during the additional study period). Score for W3 and W6 during the basic study period and W11 and W15 during the additional study period., Change in the concentration of complement system components (C3, C4) compared to the baseline result (on W1 during the basic test period and on W9 during the additional test period). Score for W3 and W6 during the basic study period and W11 and W15 during the additional study period., Change in cytokine concentration relative to the baseline result (on W1 during the basic study period and on W9 during the additional study period). Score for W3 and W6 during the basic study period and W11 and W15 during the additional study period., Change in the percentage of individual lymphocyte populations in lymphocyte immunophenotyping compared to the baseline result (on W1 during the basic study period and on W9 during the additional study period). Score for W3 and W6 during the basic study period and W11 and W15 during the additional study period., Frequency of adverse events., Change in safety parameters (blood count, creatinine, urea, bilirubin, alanine aminotransferase (ALT), aspartate aminotransferase (AST), gamma-glutamyl transpeptidase (GGTP), C-reactive protein (CRP), procalcitonin PCT, urinalysis) compared to the baseline result (on W1 during the basic test period and on W9 during the additional test period). Assessment for W3-W8 during the basic study period and W11-W15 during the additional study period., Assessment of cladribine pharmacokinetics in plasma at visits W1 (on days D1, D3 and D4) and W2.

Source: https://euclinicaltrials.eu/ctis-public/view/2024-517083-32-00